EU clinical trial 2024-520215-40-00: Evaluation of the Effect of Food, Itraconazole, and Rifampicin on the Single-Dose Pharmacokinetics of Naronapride.
Protocol code: NAT-024/BIO
Sponsor: Dr. Falk Pharma GmbH (Pharmaceutical company). Phase: Human Pharmacology (Phase I)- Other. Countries: Portugal (ended).
Therapeutic area(s): Not possible to specify
Gender: Female, Male. Age: 18-64 years. Enrolment: 48.
Status: Ended. Start date (EU): 2025-09-09. End date (EU): 2026-01-02. Decision date: 2025-08-21. Results received: No. Last updated: 2026-01-16.

Condition(s): No medical condition.

Source: https://euclinicaltrials.eu/ctis-public/view/2024-520215-40-00